EU clinical trial 2024-513959-33-00: A randomized, Phase 2, double-blind, placebo-controlled, parallel-group, 2-arm study to investigate the efficacy, safety, and tolerability of subcutaneous lunsekimig (SAR443765) in adult participants with high-risk asthma who are not currently eligible for biologic treatment
Protocol code: ACT18301
Sponsor: Sanofi-Aventis Recherche & Developpement (Pharmaceutical company). Phase: Therapeutic exploratory (Phase II). Countries: Hungary (ongoing, recruitment ended), Poland (ongoing, recruitment ended), France (ongoing, recruitment ended), Sweden (ongoing, recruitment ended), Romania (ended), Denmark (ongoing, recruitment ended), Belgium (ongoing, recruitment ended), Italy (ongoing, recruitment ended), Germany (ongoing, recruitment ended), Spain (ongoing, recruitment ended).
Therapeutic area(s): Diseases [C] - Respiratory Tract Diseases [C08]
Gender: Female, Male. Age: 18-64 years, 65+ years. Enrolment: 673.
Start date (EU): 2025-05-13. Decision date: 2025-03-18. Results received: No. Last updated: 2026-06-22.
Decision dates by country: BE: 2025-03-18, DK: 2025-03-18, HU: 2025-03-19, FR: 2025-03-18, IT: 2025-03-19, DE: 2025-03-21, RO: 2025-03-24, ES: 2025-03-18, PL: 2025-03-24, SE: 2025-03-19

Condition(s): Asthma
Product: SAR443765 / LUNSEKIMIG, Matching Placebo for Test

Primary endpoint: Annualized rate of asthma exacerbation events
Endpoint(s): Change from baseline in pre-bronchodilator (BD) forced expiratory volume in 1 second (FEV1), Change from baseline in Asthma Control Questionnaire-5 (ACQ-5) score, Change from baseline in FeNO level, Annualized rate of loss of asthma control events (LOAC) events, Annualized rate of asthma exacerbations requiring hospitalization or emergency room or urgent care visit, Total systemic corticosteroid dose exposure, Change from baseline in Asthma Quality of Life Questionnaire Standardized (AQLQ{S}) scores, Change from baseline in the Asthma Daytime Symptom Diary (ADSD) daily morning and evening score, Serum lunsekimig concentrations, Incidence and titer of anti-drug antibodies (ADA) against lunsekimig, Incidence of participants with treatment- emergent adverse events (TEAEs), including local reactions, adverse events of special interests (AESIs), serious adverse events (SAEs)

Source: https://euclinicaltrials.eu/ctis-public/view/2024-513959-33-00